EU clinical trial 2023-508697-28-00: A Phase 1/2, Multicenter, Randomized, Placebo-Controlled, Double-Blind Single Dose and Multiple Dose Study to Evaluate the Safety, Tolerability, Pharmacokinetics, and Pharmacodynamics of DNL593 in Healthy Participants and Participants With Frontotemporal Dementia Followed by an Open-Label Extension
Protocol code: DNLI-H-0001
Sponsor: Denali Therapeutics Inc. (Pharmaceutical company). Phase: Phase I and Phase II (Integrated)- First administration to humans. Countries: Netherlands (authorised, recruiting), Belgium (ongoing, recruitment ended), Spain (ongoing, recruitment ended), France (ongoing, recruitment ended), Portugal (ongoing, recruitment ended), Italy (ongoing, recruitment ended), Czechia (ended).
Therapeutic area(s): Diseases [C] - Nervous System Diseases [C10]
Gender: Female, Male. Age: 18-64 years, 65+ years. Enrolment: 55.
Start date (EU): 2024-11-13. Decision date: 2024-05-15. Results received: No. Last updated: 2026-05-29.
Decision dates by country: BE: 2024-05-24, ES: 2024-05-20, PT: 2024-06-05, CZ: 2025-09-19, IT: 2024-06-03, FR: 2024-05-28, NL: 2024-05-15

Condition(s): Frontotemporal Dementia (FTD)
Product: DNL593 Placebo, Sterile lyophilisate in single-dose glass vials, FAMOTIDINE

Primary endpoint: Incidence, severity, and seriousness of treatment-emergent adverse events (TEAEs) [Timeframe: Up to 18 months], Change from baseline in safety laboratory values, vital sign measurements, ECG results, and physical/neurological examination findings [Timeframe: Up to 18 months]
Endpoint(s): DNL593 serum PK parameters (when feasible): Cmax, tmax, Ctrough, AUClast, AUCt , t 1/2, Accumulation ratio [Timeframe: Up to 18 months], Concentration of DNL593 in cerebrospinal fluid (CSF) [Timeframe: Up to 18 months], DNL593 CSF:serum concentration ratio [Timeframe: Up to 18 months], Percentage change from baseline in plasma Nfl at Week 25

Source: https://euclinicaltrials.eu/ctis-public/view/2023-508697-28-00